EU clinical trial 2023-506963-32-00: A Phase 1/2, First-in-Human, Open-Label, Dose Escalation Study to Assess the Safety, Tolerability, Pharmacokinetics and Pharmacodynamics of mRNA 3210 in Participants with Phenylketonuria
Protocol code: mRNA 3210-P101
Sponsor: Moderna Therapeutics Inc. (Pharmaceutical company). Phase: Phase I and Phase II (Integrated)- First administration to humans. Countries: France (ended), Spain (ended), Italy (ended).
Therapeutic area(s): Diseases [C] - Nutritional and Metabolic Diseases [C18]
Gender: Female, Male. Age: 18-64 years, 65+ years. Enrolment: 16.
Status: Ended. End date (EU): 2024-09-12. Decision date: 2024-07-16. Results received: Yes. Last updated: 2024-07-16.
Decision dates by country: IT: 2024-07-16, FR: 2024-07-16, ES: 2024-07-16

Condition(s): Participants with Phenylketonuria
Product: HYDROXYZINE, PARACETAMOL, IBUPROFEN, CETIRIZINE, FEXOFENADINE, mRNA-3210, DIPHENHYDRAMINE, FAMOTIDINE

Primary endpoint: Number of participants with TEAEs.
Endpoint(s): • Changes from baseline in blood Phe levels. • Characterization of PD parameters, including Emax, AUEC, and duration of response., • Characterization of blood PK parameters of mRNA and SM 86, including, but not limited to, Cmax, Tmax, AUC, t½, CL, and Vz., • Presence and titers of anti-PEG antibodies.

Source: https://euclinicaltrials.eu/ctis-public/view/2023-506963-32-00